EU clinical trial 2023-509819-87-00: A 52 week prospective randomized controlled study to investigate the effect of intramuscular testosterone undecanoate supplementation vs placebo on intrahepatic fat content in obese men with uncontrolled type 2 diabetes (T2DM) suffering from hypogonadism with a subsequent 108 week open label phase to investigate long term effects on lipid distribution and cardiometabolic parameters in all participating men.
Sponsor: Medical University Of Vienna (Educational Institution). Phase: Therapeutic use (Phase IV). Countries: Austria (ongoing, recruiting).
Therapeutic area(s): Diseases [C] - Hormonal diseases [C19]
Gender: Male. Age: 18-64 years, 65+ years. Enrolment: 40.
Status: Ongoing, recruiting. Start date (EU): 2019-07-18. Decision date: 2024-03-18. Results received: No. Last updated: 2024-03-18.

Condition(s): hypogonadism, T2DM, prediabetes, overweight, obesity
Product: Nebido 1000 mg/4 ml Injektionslösung, Placebo to Nebido

Primary endpoint: • Change in liver fat content measured by magnetic resonance spectroscopy (MRS) from baseline to week 52

Source: https://euclinicaltrials.eu/ctis-public/view/2023-509819-87-00